EU clinical trial 2023-508254-26-00: Subtyping Primary Aldosteronism with Para-chloro-2-[18F]fluoroethyl-etomidate ([18F]CETO)
Protocol code: 2023-508254-26-00
Sponsor: Universitair Medisch Centrum Groningen (Hospital/Clinic/Other health care facility). Phase: Phase I and Phase II (Integrated)- First administration to humans. Countries: Netherlands (ongoing, recruiting).
Therapeutic area(s): Analytical, Diagnostic and Therapeutic Techniques and Equipment [E] - Diagnosis [E01]; Diseases [C] - Hormonal diseases [C19]
Gender: Female, Male. Age: 18-64 years. Enrolment: 12.
Status: Ongoing, recruiting. Start date (EU): 2024-11-06. Decision date: 2024-06-05. Results received: No. Last updated: 2024-06-05.

Condition(s): Primary aldosteronism

Source: https://euclinicaltrials.eu/ctis-public/view/2023-508254-26-00